EU clinical trial 2022-501985-23-00: A Phase 1, Multicentre, Open-Label Study to Evaluate the Pharmacokinetics, Safety, and Tolerability of a Single IV Dose of Rezafungin Acetate in Paediatric Subjects from Birth to <18 Years of Age, Receiving Systemic Antifungals as Prophylaxis for Invasive Fungal Infection or to Treat a Suspected or Confirmed Fungal Infection
Protocol code: MR907-1501
Sponsor: Mundipharma Research Limited (Pharmaceutical company). Phase: Human Pharmacology (Phase I)- Other. Countries: Germany (ended), Spain (ended).
Therapeutic area(s): Diseases [C] - Bacterial Infections and Mycoses [C01]
Gender: Female, Male. Age: 0-17 years. Enrolment: 24.
Status: Ended. Start date (EU): 2023-05-18. End date (EU): 2024-10-14. Decision date: 2023-04-18. Results received: Yes. Last updated: 2023-11-09.
Decision dates by country: DE: 2023-04-21, ES: 2023-04-18

Condition(s): Fungal infections
Product: REZZAYO 200 mg powder for concentrate for solution for infusion

Primary endpoint: Parts 1 and 2: The following PK parameters will be assessed: Cmax, Tmax, AUC0-t, AUC0-∞, CL, Vss, Vz, t1/2, Part 3: Rezafungin plasma concentrations
Endpoint(s): The safety evaluation will be based on clinical review of the following parameters: • Incidence of treatment-emergent adverse events (TEAEs) • Clinical laboratory evaluations (including haematology, blood chemistry and urinalysis) • Vital signs • 12-lead electrocardiograms (ECGs): clinically significant abnormalities • Physical examination findings

Source: https://euclinicaltrials.eu/ctis-public/view/2022-501985-23-00